EU clinical trial 2022-502611-10-00: A Phase III Multicenter, Randomized, Double-Blind, Double-Dummy, Parallel-Group Study to Evaluate the Efficacy and Safety of Fenebrutinib Compared with Ocrelizumab in Adult Patients with Primary Progressive Multiple Sclerosis
Protocol code: GN41791
Sponsor: F. Hoffmann-La Roche AG (Pharmaceutical company). Phase: Therapeutic confirmatory (Phase III). Countries: Portugal (ongoing, recruitment ended), Greece (ongoing, recruitment ended), Poland (ongoing, recruitment ended), France (ongoing, recruitment ended), Bulgaria (ongoing, recruitment ended), Italy (ongoing, recruitment ended), Hungary (ongoing, recruitment ended), Austria (ongoing, recruitment ended), Denmark (ongoing, recruitment ended), Germany (ongoing, recruitment ended), Spain (ongoing, recruitment ended).
Therapeutic area(s): Diseases [C] - Nervous System Diseases [C10]
Gender: Female, Male. Age: 18-64 years, 65+ years. Enrolment: 297.
Status: Ongoing, recruitment ended. Start date (EU): 2020-11-24. Decision date: 2024-08-21. Results received: No. Last updated: 2026-07-20.
Decision dates by country: DE: 2024-08-22, BG: 2024-09-13, IT: 2024-08-27, PT: 2024-08-21, GR: 2024-08-22, DK: 2024-08-22, AT: 2024-08-26, PL: 2024-09-02, FR: 2024-09-09, HU: 2024-08-27, ES: 2024-09-06

Condition(s): Primary Progressive Multiple Sclerosis (PPMS)

Primary endpoint: 1. Time to onset of composite 12-week confirmed disability progression (cCDP12)
Endpoint(s): 1. Time to onset of composite 24 week CDP (cCDP24), 2. Time to onset of 12-week CDP (CDP12), 3. Time to onset of 24 week CDP (CDP24), 4. Percent change in total brain volume from Week 24 as assessed by MRI scan, 5. Percent change from screening to Week 120 in serum neurofilament light chain (NfL) levels, 6. Change patient-reported physical impacts of MS (as measured by Multiple Sclerosis Impact Scale, 29-Item [MSIS-29] physical scale), 7. Time to onset of 12 week confirmed 4 point worsening in Symbol Digit Modality Test (SDMT) score, 8. The nature, frequency, timing, and severity of adverse events; serious adverse events; and adverse events leading to study treatment withdrawal, 9. Change from baseline in targeted vital signs, 10. Change from baseline in targeted ECG parameters, 11. Change from baseline in clinical laboratory results following study treatment administration, 12. Change from baseline in the proportion of patients with suicidal ideation or behavior, as assessed by Columbia Suicide Severity Rating Scale (C-SSRS), 13. Plasma concentration of fenebrutinib at specified timepoints

Source: https://euclinicaltrials.eu/ctis-public/view/2022-502611-10-00